EU clinical trial 2023-504637-42-01: Personalized, CT-guided antithrombotic therapy versus lifelong single antiplatelet therapy to reduce thromboembolic and bleeding events in non-atrial fibrillation patients after transcatheter aortic valve implantation: a pragmatic, international, multicentre, randomized clinical trial (POPular ATLANTIS trial)
Sponsor: St Antonius Hospital (Hospital/Clinic/Other health care facility). Phase: Therapeutic use (Phase IV). Countries: Netherlands (ongoing, recruiting), France (ongoing, recruiting), Belgium (ongoing, recruiting), Denmark (ongoing, recruiting), Germany (authorised, recruitment pending).
Therapeutic area(s): Diseases [C] - Cardiovascular Diseases [C14]
Gender: Female, Male. Age: 65+ years. Enrolment: 2600.
Start date (EU): 2023-12-21. Decision date: 2023-11-16. Results received: No. Last updated: 2025-08-25.
Decision dates by country: BE: 2025-07-09, DK: 2025-07-25, DE: 2025-07-23, NL: 2023-11-16, FR: 2024-05-03

Condition(s): aortic valve stenosis
Product: Ticagrelor Mylan 90 mg film-coated tablets, Acetylsalicylzuur Cardio Mylan 80 mg, dispergeerbare tabletten, COUMADINE 2 mg, comprimé sécable, Fenprocoumon Sandoz 3 mg, tabletten, Eliquis 5 mg film-coated tablets, Prasugrel Teva 10 mg Film-coated Tablets, Acenocoumarol Sandoz 1 mg, tabletten, MINI-SINTROM 1 mg, comprimé, Warfarin Teva 2.5 mg Tablets, Eliquis 2.5 mg film-coated tablets, KARDEGIC 75 mg, poudre pour solution buvable en sachet-dose, Clopidogrel Xiromed 75 mg filmomhulde tabletten

Primary endpoint: The primary endpoints are thromboembolic and bleeding events: Thromboembolic events, defined as the composite of cardiovascular mortality, ischaemic stroke, transient ischaemic attack, myocardial infarction, systemic embolism and clinically significant valve thrombosis according to the VARC-3 criteria. All bleeding, defined as the composite of type 1-4 bleeding, according to the VARC-3 criteria.
Endpoint(s): Net clinical benefit, defined as the composite of cardiovascular mortality, stroke, transient ischaemic attack, systemic embolism, clinically significant valve thrombosis and type 1-4 bleeding according to the VARC-3 criteria., Major bleeding (VARC-3 type 2-4), Cerebrovascular events (All stroke and TIA according to VARC-3), Cardiovascular mortality, All-cause mortality, Aortic bio-prosthetic valve dysfunction assessed by echocardiography yearly after TAVI (standard care)., Quality of life as assessed by EuroQol- 5 Dimension 5 Level (EQ-5D-5L), Kansas City Cardiomyopathy Questionnaire (KCCQ) and Short Form Health Survey (SF-12) at baseline, 3 and 12 months, and then yearly after TAVI procedure., Medication adherence as assessed by the Medication Adherence Report Scale (MARS-5) yearly after randomization., To evaluate the cost-effectiveness of a CT-guided antithrombotic strategy after TAVI.

Source: https://euclinicaltrials.eu/ctis-public/view/2023-504637-42-01